EU clinical trial 2023-503893-19-00: A Phase IIIb, multi-center, non-randomized, parallel-group, open-label, hybrid type I study evaluating the efficacy, safety, implementation effectiveness, and patient-reported outcomes of oral dolutegravir/lamivudine once-daily as a first-line regimen followed by participant-determined optional switch to long-acting intramuscular cabotegravir plus rilpivirine every two months for the maintenance of virologic suppression in antiretroviral therapy naive adults living with HIV-1.
Protocol code: 219700
Sponsor: Viiv Healthcare UK Limited (Pharmaceutical company). Phase: Therapeutic confirmatory (Phase III). Countries: Italy (ended), France (ended), Spain (ended), Germany (ended).
Therapeutic area(s): Diseases [C] - Virus Diseases [C02]
Gender: Female, Male. Age: 18-64 years, 65+ years. Enrolment: 67.
Status: Ended. Start date (EU): 2023-12-06. End date (EU): 2026-02-05. End date: 2026-04-20. Decision date: 2023-11-16. Results received: No. Last updated: 2026-01-28.
Decision dates by country: FR: 2023-11-16, DE: 2023-11-20, IT: 2023-11-17, ES: 2023-11-17

Condition(s): HIV-1 infection
Product: Dovato 50 mg/300 mg film-coated tablets, Dovato 50 mg/300 mg film-coated tablets, REKAMBYS 900 mg prolonged-release suspension for injection, Vocabria 400 mg prolonged-release suspension for injection, Vocabria 600 mg prolonged-release suspension for injection

Primary endpoint: •Time to virologic suppression (HIV viral load less than 50 copies per milliliter [c/mL]) from Day 1 (DTG/3TC)., • Participant with HIV viral load less than 50 c/mL as per the Snapshot algorithm after 1 year on treatment (CAB + RPV LA).
Endpoint(s): • Participant with plasma HIV-1 RNA <50 c/mL as per Snapshot algorithm at Month 12 (DTG/3TC)., • Participant with plasma HIV-1 RNA greater than or equal to 50 c/mL as per Snapshot algorithm at Month 12 (DTG/3TC) / Month 11 (CAB + RPV LA)., • Participant with plasma HIV-1 RNA <50 c/mL and <200 c/mL over time, from Baseline (Day 1) through Day of Choice (all participants) and through Month 12 (DTG/3TC) / Month 11 (CAB + RPV LA)., • Absolute values and change from Baseline (Day 1) in plasma HIV-1 RNA (log10 c/mL) through Day of Choice (all participants) and Month 12 (DTG/3TC)., • Absolute values and changes from Baseline (Day 1) in CD4+ cell count over time including through Day of Choice (all participants) and Month 12 (DTG/3TC) / Month 11 (CAB + RPV LA)., • Participant meeting confirmed virologic failure (CVF) criteria over time., • Occurrence of disease progression (HIV-associated conditions, acquired immunodeficiency syndrome [AIDS] and death) through Day of Choice (all participants) and through Month 12 (DTG/3TC) / Month 11 (CAB + RPV LA)., • Occurrence of viral resistance to CAB, RPV, DTG and 3TC through Day of Choice (all participants) and through Month 12 (DTG/3TC) / Month 11 (CAB + RPV LA)., • Occurrence of serious AEs; drug-related AEs (excluding injection site reactions [ISRs]); and AEs leading to discontinuation of study intervention, over time including through Day of Choice (all participants) and through Month 12 (DTG/3TC) / Month 11 (CAB + RPV LA)., • Change from Baseline (Week 4) in total “treatment satisfaction” score, and individual item scores of the HIV Treatment Satisfaction Status Questionnaire (HIVTSQs) at Day of Choice, Month 6 (DTG/3TC) / Month 5 (CAB + RPV LA) and Month 12 (DTG/3TC) / Month 11 (CAB + RPV LA) or Withdrawal., • Change in total score and individual bothersome symptoms from Baseline (Day 1) to Day of Choice; and Day of Choice to Month 6 and Month 12 (DTG/3TC) using the Symptom Distress Module (SDM)., • Change in health-related quality of life across six domains from Baseline (Day 1) to Day of Choice; and Day of Choice to Month 5 and 11 for participants receiving CAB + RPV LA; Baseline (Day 1) to Day of Choice, Month 6 and Month 12 for participants receiving DTG/3TC using the WHOQoL-HIV-BREF., • Change in anxiety and depression score from Baseline (Day 1) to Day of Choice; and Day of Choice to Months 5/6 and 11/12 for participants receiving DTG/3TC and CAB + RPV LA using the Patient Health Questionnaire 9 (PHQ-9) and General Anxiety Disorder 7 (GAD-7)., • Change in response to single item questions from Baseline (Day 1 or Week 4) to Day of Choice; and Day of Choice to Months 5/6 and 11/12 for participants receiving CAB + RPV LA and DTG/3TC using bespoke questions., • Change in response to assessments from Day of Choice to Month 5 and to Month 11 for participants on CAB + RPV LA using ViiV Healthcare-developed single-item questions.

Source: https://euclinicaltrials.eu/ctis-public/view/2023-503893-19-00